EU clinical trial 2024-514332-25-00: Influence of Argipressin on blood loss during liver resection; a double-blinded, randomized, placebo-controlled trial (ARG-01)
Protocol code: ARG-01
Sponsor: Vaestra Goetalandsregionen (Hospital/Clinic/Other health care facility). Phase: Therapeutic exploratory (Phase II). Countries: Sweden (ended).
Therapeutic area(s): Diseases [C] - Neoplasms [C04]
Gender: Female, Male. Age: 18-64 years, 65+ years. Enrolment: 248.
Status: Ended. Start date (EU): 2022-03-27. End date (EU): 2025-02-17. Decision date: 2024-11-14. Results received: Yes. Last updated: 2024-11-14.

Condition(s): Hepatic resection due to primary malignant disease, metastasis or benign tumour
Product: Empressin 40 IE/2 ml koncentrat till infusionsvätska, lösning, Natriumklorid Braun 9 mg/ml injektionsvätska, lösning

Primary endpoint: Blood loss (ml) at the end of surgery, measured according to the investigator’s instructions, by visual assessment of suction devices and gauze, and subtraction of ascites and irrigation fluids.
Endpoint(s): Blood transfusion (ml) at the end of surgery, and at postoperative day 1 and postoperative day 2 or 5, respectively as well as plasma and thrombocytes day 2/5., Levels of WBC, CRP, PLT and Albumin at the end of surgery and postoperative day 1-5., Levels of IL-1b IL-6, IL-8, IL-10, MCP-1, SDF-1a, ICAM, C3a, C5b-9 at the end of surgery and postoperative day 1 and 2., ROTEM, vWF activity, factor VIII at the end of surgery and postoperative day 1., Plasma creatinine will be controlled at postoperative day 1, 2 and 5. Urine [TIMP-2] x [IGFBP-7] will be controlled after surgery., Hs-TNI will be controlled at the end of surgery and at postoperative day 1., Arterial lactate will be controlled at the end of surgery, at three hours after surgery and at postoperative day 1., IFABP will be controlled at three hours after surgery and postoperative day one., Vasopressor use during surgery, achievement of CVP goal, total urine output and use of furosemide at postoperative day 1., Measurements of mean arterial blood pressure (MAP), heart rate, CVP and Cardiac Index (if applicable), as well as assessment of capillary refill time in digits at the end of surgery., Total time of surgical hepatic occlusion and radicality of resection, as well as use of TXA., Length of stay in hospital and postoperative complications documented at postoperative day 30.

Source: https://euclinicaltrials.eu/ctis-public/view/2024-514332-25-00